EU clinical trial 2024-512674-97-00: Evaluation of the bioequivalence of two products containing esomeprazole under fed conditions: Esomeprazole-Syrup 40 mg dose (Test) vs. Nexium 40 mg (Comparator). An open, randomized, single dose, four-period, replicate, crossover trial in healthy volunteers
Protocol code: CBP23003
Sponsor: CCDRD Cooperative Clinical Drug Research and Development AG, BePharBel Manufacturing (Pharmaceutical company). Phase: Human Pharmacology (Phase I)- Bioequivalence Study. Countries: Bulgaria (ended).
Therapeutic area(s): Diseases [C] - Digestive System Diseases [C06]
Gender: Female, Male. Age: 18-64 years. Enrolment: 54.
Status: Ended. Start date (EU): 2025-03-11. End date (EU): 2025-05-19. Decision date: 2025-03-10. Results received: No. Last updated: 2025-03-10.

Condition(s): No therapeutic indication in the current trial with healthy volunteers.

Source: https://euclinicaltrials.eu/ctis-public/view/2024-512674-97-00